EU clinical trial 2023-504923-20-00: A Phase 3, Randomized, Double-blind, Placebo- and Active-Comparator-Controlled Clinical Study of Adjuvant V940 (mRNA-4157) Plus Pembrolizumab Versus Adjuvant Placebo Plus Pembrolizumab in Participants With Resected Stage II, IIIA, IIIB (N2) Non-small Cell Lung Cancer (INTerpath-002)
Protocol code: V940-002
Sponsor: Merck Sharp & Dohme LLC (Pharmaceutical company). Phase: Therapeutic confirmatory (Phase III). Countries: Poland (ongoing, recruiting), Norway (ongoing, recruitment ended), Hungary (ongoing, recruitment ended), Slovakia (ongoing, recruitment ended), Finland (ongoing, recruitment ended), Greece (ongoing, recruiting), Estonia (ongoing, recruitment ended), Denmark (ongoing, recruitment ended), Portugal (ongoing, recruitment ended), France (ongoing, recruitment ended), Ireland (ongoing, recruiting), Germany (ongoing, recruiting), Latvia (ongoing, recruitment ended), Czechia (ongoing, recruitment ended), Lithuania (ongoing, recruitment ended), Belgium (ongoing, recruitment ended), Spain (ongoing, recruitment ended), Italy (ongoing, recruiting).
Therapeutic area(s): Diseases [C] - Neoplasms [C04]
Gender: Female, Male. Age: 18-64 years, 65+ years. Enrolment: 503.
Start date (EU): 2024-04-04. Decision date: 2024-03-22. Results received: No. Last updated: 2026-07-03.
Decision dates by country: PT: 2024-04-09, IT: 2024-04-05, EE: 2024-03-27, FR: 2024-03-27, ES: 2024-03-26, PL: 2024-03-25, CZ: 2024-03-27, IE: 2024-03-27, FI: 2024-03-25, LV: 2024-03-27, HU: 2024-03-27, DE: 2024-03-27, GR: 2024-03-26, BE: 2024-03-25, NO: 2024-03-22, SK: 2024-03-26, DK: 2024-03-26, LT: 2024-03-27

Condition(s): Stage II, IIIA, IIIB (N2) Non-small Cell Lung Cancer
Product: mRNA-4157, KEYTRUDA 25 mg/mL concentrate for solution for infusion, Saline solution for Placebo to v940 (mrna-4157)

Primary endpoint: Disease-Free Survival (DFS)
Endpoint(s): Overall Survival (OS), Distant Metastasis-Free Survival (DMFS), Lung Cancer Specific Survival (LCSS), Change from Baseline in the European Organization for Research and Treatment of Cancer (EORTC)-Quality of Life Questionnaire-Core 30 (QLQ-C30) Global Health Status/Quality of Life (Items 29 and 30) Combined Score, Change from Baseline in the EORTC QLQ-C30 Physical Functioning (Items 1-5) Combined Score on the EORTC QLQ-C30, Change from Baseline in the EORTC QLQ-C30 Role Functioning (Items 6 and 7) Combined Score on the EORTC QLQ-C30, Change from Baseline in the EORTC QLQ-C30 Dyspnea (Item 8) Score on the EORTC QLQ-C30, Change from Baseline in the EORTC QLQ-Lung Cancer Questionnaire (LC24) Coughing (Items 31 and 52) Combined Score on the EORTC QLQ-LC24, Change from Baseline in the EORTC QLQ-LC24 Chest Pain (Item 40) Score on the EORTC QLQ-LC24, Number of Participants Who Experience an Adverse Event (AE), Number of Participants Who Discontinue Study Treatment Due to an AE

Source: https://euclinicaltrials.eu/ctis-public/view/2023-504923-20-00